EU clinical trial 2023-504159-29-01: Safety and efficacy of oral semaglutide in hyperglycaemic patients after renal transplantation
Sponsor: Rigshospitalet (Hospital/Clinic/Other health care facility). Phase: Therapeutic exploratory (Phase II). Countries: Denmark (ongoing, recruiting).
Therapeutic area(s): Diseases [C] - Nutritional and Metabolic Diseases [C18]
Gender: Female, Male. Age: 18-64 years, 65+ years. Enrolment: 104.
Status: Ongoing, recruiting. Start date (EU): 2024-09-03. Decision date: 2023-08-17. Results received: No. Last updated: 2025-11-03.

Condition(s): Hyperglycaemia after renal transplantation
Product: PLACEBO, Rybelsus 3 mg tablets, Rybelsus 7 mg tablets, Rybelsus 14 mg tablets

Primary endpoint: Mean sensor glucose (mmol/L) evaluated by CGM
Endpoint(s): Percentage time in target range (3.9–10.0 mmol/L) as evaluated by CGM, Percentage time in tight glycaemic range (3.9–7.8 mmol/L), Percentage time in hyperglycaemia (level 1 (10.1–13.9 mmol/L) and level 2 (above 13.9 mmol/L) evaluated by CGM, Glucose variability (standard deviation [mmol/L] and coefficient of variation [%]) evaluated by CGM, Glucose management indicator (mmol/mol and %) evaluated by CGM, HbA1c (mmol/mol and %), Body weight (kg), Body mass index (BMI) expressed as kg/m2, Creatinine (µmol/L), eGFR (ml/min/1.73m2), Systolic blood pressure (mmHg), Diastolic blood pressure (mmHg), Pulse (beats-per-min), Urinary albumin-to-creatinine ratio (mg/g), Plasma concentrations of cholesterol, low-and high-density lipoproteins (LDL and HDL, respectively) and triglycerides, Daily insulin dose (IE per day), Daily dose of immunosuppressant (prednisone, cyclosporine, tacrolimus, mycophenolate mofetile), Plasma concentration of semaglutide (nmol/L), Plasma insulin (pmol/L), C-peptide (nmol/L), Homeostatic model assessment (HOMA) for assessing beta-cell function and insulin resistance, Blood concentrations of cyclosporine (µg/L) and tacrolimus (µg/L), Dose-corrected plasma semaglutide concentration (nmol/L), Plasma alanine transaminase (ALAT) (U/L), Plasma amylase (U/L), Gastrointestinal side effects evaluated using the Gastrointestinal symptom rating scale (GSRS) (Consist of 15 gastrointestinal symptoms that are each rated on a 7-point scale with 1 being "no discomfort" and 7 being "very severe discomfort"), Incidence of adverse events, Incidence of serious adverse events, Incidence of self-reported hypoglycaemic episodes, Incidence of out-of-target measures of blood tacrolimus and blood ciclosporin, Incidence of 25% increase in creatinine from discharge after renal transplantation, Incidence of admissions, Incidence of admissions due to dehydration, Incidence of renal graft rejection, Incidence of renal graft failure (defined as return to dialysis)

Source: https://euclinicaltrials.eu/ctis-public/view/2023-504159-29-01